EU clinical trial 2023-505866-27-00: A Phase III Prospective, Multicenter, Randomized, Open-Label Trial of Acalabrutinib plus Venetoclax versus Venetoclax plus Obinutuzumab in Previously Untreated Chronic Lymphocytic Leukemia or Small Lymphocytic Lymphoma
Protocol code: D8220C00027
Sponsor: Astrazeneca AB (Pharmaceutical company). Phase: Therapeutic confirmatory (Phase III). Countries: Czechia (ongoing, recruitment ended), Poland (ongoing, recruitment ended), France (ongoing, recruitment ended), Hungary (ongoing, recruitment ended), Spain (ongoing, recruitment ended).
Therapeutic area(s): Diseases [C] - Neoplasms [C04]
Gender: Female, Male. Age: 18-64 years, 65+ years. Enrolment: 387.
Status: Ongoing, recruitment ended. Start date (EU): 2022-10-28. Decision date: 2024-03-15. Results received: No. Last updated: 2026-02-11.
Decision dates by country: CZ: 2024-03-18, ES: 2024-03-15, FR: 2024-03-21, PL: 2024-03-20, HU: 2024-03-19

Condition(s): Chronic Lymphocytic Leukemia or Small Lymphocytic Lymphoma
Product: Gazyvaro 1,000 mg concentrate for solution for infusion., Venclyxto 10 mg film-coated tablets, Venclyxto 100 mg film-coated tablets, Venclyxto 50 mg film-coated tablets, Calquence 100 mg film-coated tablets, Venclyxto 100 mg film-coated tablets, Calquence 100 mg film-coated tablets, Venclyxto 100 mg film-coated tablets, Venclyxto 50 mg film-coated tablets, Calquence 100 mg hard capsules, Venclyxto 10 mg film-coated tablets, Calquence 100 mg hard capsules

Primary endpoint: PFS, defined as the time from the date of randomization until date of objective progressive disease per iwCLL 2018 criteria as assessed by the investigator or death from any cause in the absence of progression
Endpoint(s): Rate of peripheral blood uMRD, Overall survival, Event-free survival, Overall response rate, CR rate after completion of 12 cycles of venetoclax, Change from baseline in EORTC QLQ-C30, EORTC QLQ-CLL17 scales, Proportion of participants experiencing bruising, Proportion of participants reporting each response option of the PGI-BR

Source: https://euclinicaltrials.eu/ctis-public/view/2023-505866-27-00